EU clinical trial 2025-524086-24-00: Efficacy of Dexmedetomidine on Emergence Delirium in Children Undergoing Adenotonsillectomy: A Double-Blind Randomized Controlled Trial with Heart Rate Variability and Electroencephalography-Guided Anesthesia
Protocol code: DEXPAED
Sponsor: Akershus University Hospital (Hospital/Clinic/Other health care facility). Phase: Therapeutic confirmatory (Phase III). Countries: Norway (authorised, recruitment pending).
Therapeutic area(s): Diseases [C] - Nervous System Diseases [C10]
Gender: Female, Male. Age: 0-17 years. Enrolment: 255.
Status: Authorised, recruitment pending. Decision date: 2026-04-15. Results received: No. Last updated: 2026-04-15.

Condition(s): Emergence delirium
Product: Dexmedetomidine B. Braun 100 mikrogram/ml konsentrat til infusjonsvæske, oppløsning, Natriumklorid B. Braun 9 mg/ml oppløsningsvæske til parenteral bruk

Primary endpoint: Emergence delirium (ED), defined as a Pediatric Anesthesia Emergence Delirium (PAEDs) score ≥ 10 in the time between waking up, until 45 minutes after waking up; measured at 15, 30, and 45 minutes after waking up, or whenever there are signs of ED within this time frame. This is a dichotomous endpoint recorded as "ED present" if PAEDs score ≥ 10 and "absent” otherwise.
Endpoint(s): Emergence delirium, defined as a Richmond Agitation-Sedation Scale score > 0 in the time between waking up, until 45 minutes after waking up; measured at 15, 30, and 45 minutes after waking up or whenever there are signs of emergence delirium within this time frame. This is a dichotomous endpoint recorded as "emergence delirium present" if Richmond Agitation-Sedation Scale score > 0 and "absent” otherwise., Level of pain during the first 45 minutes after waking up will be measured with the Face Legs Activity Cry Consolation score, Nurse Numeric Rating Scale score, and Parental Numeric Rating Scale score., Level of pain during the stay in the Post-Anesthesia Care Unit. Measured with total opioid analgesic consumption., Length of stay during anesthesia and in the Post-Anesthesia Care Unit. Departure from the Post-Anesthesia Care Unit will follow the local discharge criteria., Postoperative nausea and vomiting in the Post-Anesthesia Care Unit and in the initial 24-hour postoperative period will be measured with the Baxter Retching Faces scale., The parental satisfaction score will be measured with the Pediatric Anesthesia Parent Satisfaction score., The frequency of adverse events, after investigestional medicinal product administration, in the intervention groups., The frequency of systolic blood pressure hypotension, after investigestional medicinal product administration, in the intervention groups.

Source: https://euclinicaltrials.eu/ctis-public/view/2025-524086-24-00